EU clinical trial 2024-512859-21-00: Fully hybrid 18F-PSMA PET/MRI as one-stop approach for the diagnosis of clinically significant prostate cancer
Sponsor: Ospedale San Raffaele S.r.l. (Hospital/Clinic/Other health care facility). Phase: Therapeutic exploratory (Phase II). Countries: Italy (ongoing, recruiting).
Therapeutic area(s): Diseases [C] - Neoplasms [C04]
Gender: Male. Age: 18-64 years, 65+ years. Enrolment: 167.
Status: Ongoing, recruiting. Start date (EU): 2023-12-04. Decision date: 2024-10-21. Results received: No. Last updated: 2025-06-25.

Condition(s): Patients with clinical suspicion of clinically relevant prostate cancer
Product: [18F]PSMA-1007

Primary endpoint: Diagnostic accuracy measured by sensitivity, specificity, and positive and negative predictive values

Source: https://euclinicaltrials.eu/ctis-public/view/2024-512859-21-00